EU clinical trial 2023-503814-62-00: Tenofovir Alafenamide Fumarate and Epstein-Barr virus activity in people with MS – The TAF-MS study
Sponsor: Helse Bergen HF (Hospital/Clinic/Other health care facility). Phase: Therapeutic exploratory (Phase II). Countries: Norway (ended).
Therapeutic area(s): Diseases [C] - Nervous System Diseases [C10]
Gender: Female, Male. Age: 18-64 years. Enrolment: 50.
Status: Ended. Start date (EU): 2024-02-06. End date (EU): 2025-11-14. Decision date: 2023-11-20. Results received: No. Last updated: 2024-11-08.

Condition(s): Multiple sclerosis
Product: Capsule coated tablets, Tysabri 300 mg concentrate for solution for infusion, Vemlidy 25 mg film-coated tablets.

Primary endpoint: Total number of SAEs from baseline to 24 weeks after start of study treatment
Endpoint(s): Change in IgG antibodies to EBNA1 and other EBV antigens from baseline to 2, 8 and 24 weeks after start of study treatment., Change in EBV viral load in saliva from baseline to 2, 8 and 24 weeks after start of study treatment., Key secondary endpoints Change in EBV shedding in saliva

Source: https://euclinicaltrials.eu/ctis-public/view/2023-503814-62-00